EU clinical trial 2024-515407-19-00: PANOVA-4: Pilot, Single arm Study of Tumor Treating Fields (TTFields, 150kHz) Concomitant with Atezolizumab, Gemcitabine and Nab-Paclitaxel as First-Line Treatment for Metastatic Pancreatic Ductal Adenocarcinoma (mPDAC)
Protocol code: EF-39
Sponsor: Novocure GmbH (Pharmaceutical company). Phase: Therapeutic confirmatory (Phase III). Countries: Spain (ended), Germany (ended), Czechia (ended).
Therapeutic area(s): Diseases [C] - Digestive System Diseases [C06]
Gender: Female, Male. Age: 18-64 years, 65+ years. Enrolment: 72.
Status: Ended. Start date (EU): 2023-08-16. End date (EU): 2026-01-15. End date: 2026-01-16. Decision date: 2024-10-16. Results received: No. Last updated: 2025-11-19.
Decision dates by country: CZ: 2024-10-18, DE: 2024-10-16, ES: 2024-10-16

Condition(s): Metastatic pancreatic ductal adenocarcinoma (mPDAC)
Product: Tecentriq 840 mg concentrate for solution for infusion

Primary endpoint: Disease control rate (DCR) by RECIST v1.1 in patients with 1L mPDAC treated with TTFields concomitant with atezolizumab, gemcitabine and nab-paclitaxel, measured as the proportion of patients with stable disease for at least 16 weeks or confirmed PR or CR.
Endpoint(s): 1. Overall survival (OS) in patients with 1L mPDAC treated with TTFields concomitant with atezolizumab, gemcitabine and nab-paclitaxel, measured as the period between the time of treatment initiation and the time of death., NOTE: A full list of secondary endpoints is available in the section 3.2.2 (page 26) of the study protocol.

Source: https://euclinicaltrials.eu/ctis-public/view/2024-515407-19-00